EU clinical trial 2025-522946-37-00: A Phase 3, Multi-Site, Prospective, Randomized, Double-Blind, Placebo-Controlled Trial of eRapa to Improve Clinical Outcomes in Participants with Familial Adenomatous Polyposis
Protocol code: MTX230-301
Sponsor: Biodexa Limited, Rapamycin Holdings Inc. (Pharmaceutical company). Phase: Therapeutic confirmatory (Phase III). Countries: Denmark (ongoing, recruiting), Spain (ongoing, recruiting), Germany (ongoing, recruiting), Netherlands (ongoing, recruiting), Italy (authorised, recruiting).
Therapeutic area(s): Diseases [C] - Virus Diseases [C02]
Gender: Female, Male. Age: 18-64 years, 65+ years. Enrolment: 82.
Start date (EU): 2025-11-24. Decision date: 2025-10-27. Results received: No. Last updated: 2026-06-30.
Decision dates by country: DE: 2025-10-28, IT: 2026-02-16, ES: 2025-10-30, NL: 2025-10-31, DK: 2025-10-27

Condition(s): Familial adenomatous polyposis (FAP)
Product: White opaque capsule filled with a white to off- white powder, eRapa

Primary endpoint: Progression-free survival (PFS) in high-risk patients with FAP treated with eRapa versus placebo. Disease progression is defined as a FAP-specific, clinically significant event. FAP-specific progression events will be defined as follows: Death from any cause • Cancer/high-grade dysplasia • Major FAP-related surgery (e.g., colectomy, proctectomy, total proctocolectomy with ileal pouch anal anastomosis [IPAA], pouch resection, ileostomy, duodenectomy, or surgical ampullectomy)
Endpoint(s): Frequency of all grades (as per the Common Terminology Criteria for Adverse Events [CTCAE] version [v] 5.0) treatment-emergent adverse events (TEAEs) in participants receiving eRapa, Frequency of Grade 3 and higher (as per the CTCAE v5.0) TEAEs in participants receiving eRapa, Percentage of participants discontinuing eRapa treatment due to adverse drug reactions (ADRs), Percent change from baseline in the PB (i.e., the sum of the diameters of all polyps >3 mm) at 6, 12, 18, 24, 30, and 36 months as observed by surveillance endoscopy Note: The total PB will be based on polyps observed in the upper GI tract (duodenum) and the lower GI tract (colon, retained rectum/sigmoid or pouch), Percent change from baseline in the PB in the upper GI tract (duodenum) at 6, 12, 18, 24, 30, and 36 months as observed by upper endoscopy, Percent change from baseline in the PB in the lower GI tract (colon, retained rectum/ sigmoid or pouch) at 6, 12, 18, 24, 30, and 36 months as observed by lower endoscopy, Change from baseline in Spigelman stage score at 6, 12, 18, 24, 30, and 36 months, Change from baseline in EQ-5D5L score at 6, 12, 18, 24, 30, and 36 months, Change from baseline in EORTC QLQ-30 score at 6, 12, 18, 24, 30, and 36 months

Source: https://euclinicaltrials.eu/ctis-public/view/2025-522946-37-00